EU clinical trial 2025-522305-38-00: Impact of Biweekly and Triweekly Dosing Regimens on Progression-Free Survival in First-Line FOLFIRI Treatment of Metastatic Colorectal Cancer: A Non-Inferiority Study (FIR-DIR)
Sponsor: University Of Pecs (Educational Institution). Phase: Therapeutic exploratory (Phase II). Countries: Hungary (authorised, recruitment pending).
Therapeutic area(s): Diseases [C] - Digestive System Diseases [C06]; Diseases [C] - Neoplasms [C04]
Gender: Female, Male. Age: 18-64 years, 65+ years. Enrolment: 56.
Status: Authorised, recruitment pending. Decision date: 2025-07-18. Results received: No. Last updated: 2025-07-18.

Condition(s): Metastatic colorectal cancer
Product: IRINOTECAN, CALCIUM FOLINATE, FLUOROURACIL

Primary endpoint: Progression-Free Survival (PFS) assessed by the investigators
Endpoint(s): Overall Survival (OS) data in both treatment arms, Time on treatment (ToT) periods in both treatment arms, AE, SAE events by CTCAE v.5.

Source: https://euclinicaltrials.eu/ctis-public/view/2025-522305-38-00